EU clinical trial 2023-509274-28-00: A randomized, two-arm, placebo-controlled, participant, investigator and sponsor-blinded, proof-of-concept study investigating the efficacy, safety and tolerability of QUC398 in patients with symptomatic knee osteoarthritis
Protocol code: CQUC398A12201
Sponsor: Novartis Pharma AG (Pharmaceutical company). Phase: Therapeutic exploratory (Phase II). Countries: Denmark (ended), Spain (ended), France (ended).
Therapeutic area(s): Diseases [C] - Musculoskeletal Diseases [C05]
Gender: Female, Male. Age: 18-64 years, 65+ years. Enrolment: 76.
Status: Ended. Start date (EU): 2023-02-03. End date (EU): 2025-04-08. End date: 2025-04-09. Decision date: 2024-04-26. Results received: Yes. Last updated: 2024-12-20.
Decision dates by country: FR: 2024-05-02, ES: 2024-04-29, DK: 2024-04-26

Condition(s): Knee osteoarthritis
Product: PARACETAMOL, Placebo to QUC398 150 mg/1 mL Solution for injection, QUC398, Paracetamol/Codeine phosphate hemihydrate Accord 500 mg/30 mg tablets

Primary endpoint: Change from baseline in Knee Injury and Osteoarthritis Outcome Score (KOOS) Pain sub-scale at Week 12
Endpoint(s): Change from baseline in cartilage volume of the knee index region at Week 52, as determined from the automated segmentation of 3D-MRI scans, Change from baseline in KOOS Pain subscale at Weeks 1 (Day 5), 4, 8, 12, 16, 20, 24, 28, 32, 36, 40, 44, 48, and 52, Change from baseline in pain assessed by a Pain Numerical Rating Scale (NRS) at Weeks 1 (Day 5), 4, 8, 12, 16, 20, 24, 28, 32, 36, 40, 44, 48, and 52, Change from baseline in total KOOS at Weeks 1 (Day 5), 4, 8, 12, 16, 20, 24, 28, 32, 36, 40, 44, 48, and 52, Change from baseline in KOOS subscales: Other symptoms, Function in daily living, Function in sport and recreation, and Knee related quality of life at Weeks 1 (Day 5), 4, 8, 12, 16, 20, 24, 28, 32, 36, 40, 44, 48, and 52, Change from baseline in Patient's Global Assessment (PGA) as assessed by NRS at Weeks 1 (Day 5), 4, 8, 12, 16, 20, 24, 28, 32, 36, 40, 44, 48, and 52, Systemic and local Treatment Emergent Adverse Events (TEAEs) and Serious TEAEs, Electrocardiogram parameters (ECGs), Vital signs, Laboratory tests (Hematology, blood chemistry, coagulation and urinalysis), Echo-Doppler of thoracic and abdominal aorta

Source: https://euclinicaltrials.eu/ctis-public/view/2023-509274-28-00